EU clinical trial 2023-510161-97-00: An Open-label, Single-dose Study to Evaluate the Effect of Renal Impairment on the Pharmacokinetics of JNJ-77242113 in Adult Participants
Protocol code: 77242113PSO1007
Sponsor: Janssen Cilag International (Pharmaceutical company). Phase: Human Pharmacology (Phase I)- Other. Countries: Germany (ended).
Therapeutic area(s): Diseases [C] - Immune System Diseases [C20]
Gender: Female, Male. Age: 18-64 years, 65+ years. Enrolment: 28.
Status: Ended. Start date (EU): 2024-06-19. End date (EU): 2025-03-10. Decision date: 2024-05-13. Results received: No. Last updated: 2025-01-21.

Condition(s): Renal Impairment

Source: https://euclinicaltrials.eu/ctis-public/view/2023-510161-97-00